EU clinical trial 2022-503060-33-00: A Phase 1/2 Dose Escalation/Expansion Study of NGM707 as Monotherapy and in Combination with Pembrolizumab in Advanced or Metastatic Solid Tumor Malignancies
Protocol code: NGM707-IO-101
Sponsor: Ngm Biopharmaceuticals Inc. (Pharmaceutical company). Phase: Therapeutic exploratory (Phase II). Countries: France (ended), Italy (ended), Spain (ended).
Therapeutic area(s): Diseases [C] - Neoplasms [C04]
Gender: Female, Male. Age: 18-64 years, 65+ years. Enrolment: 45.
Status: Ended. End date (EU): 2025-01-14. Decision date: 2023-07-04. Results received: No. Last updated: 2023-07-10.
Decision dates by country: IT: 2023-07-04, ES: 2023-07-05, FR: 2023-07-10

Condition(s): Advanced or Metastatic Solid Tumor Malignancies
Product: NGM707, pembrolizumab

Primary endpoint: " Treatment-emergent AEs characterized by type, frequency, severity (graded by NCI CTCAE v5.0), timing, seriousness, and relationship to study drug", " Objective tumor response (ORR) as per RECIST v1.1"
Endpoint(s): " Trough concentrations of NGM707 for selected cycles", " Incidence and titers of ADA and nAb against NGM707", " DCR, DOR, PFS as per RECIST v1.1 as assessed by the Investigator and overall survival "

Source: https://euclinicaltrials.eu/ctis-public/view/2022-503060-33-00